EU clinical trial 2024-519908-27-01: Estrogen replacement therapy (ERT) for treatment of adolescent anorexia nervosa – An open label study
Protocol code: HNF1595-21
Sponsor: Universitetssykehuset Nord-Norge HF (Hospital/Clinic/Other health care facility). Phase: Therapeutic exploratory (Phase II). Countries: Norway (ended).
Therapeutic area(s): Psychiatry and Psychology [F] - Mental Disorders [F03]
Gender: Female. Age: 0-17 years. Enrolment: 36.
Status: Ended. End date (EU): 2026-04-14. Decision date: 2025-01-24. Results received: No. Last updated: 2025-01-24.

Condition(s): Anorexia Nervosa
Product: Estradot 50 mikrog/24 timer depotplaster

Primary endpoint: Anxiety levels measured by STAI-C and specific symptoms of anorexia measured by the EDE-Q
Endpoint(s): Cortisol, ghrelin, T3, T4 levels, weight gain, cognitive performance (WCST, CVLT II), and Beck Youth Inventory scores

Source: https://euclinicaltrials.eu/ctis-public/view/2024-519908-27-01